EU clinical trial 2023-508209-25-00: A study to learn how safe and tolerable odronextamab and cemiplimab are in adult patients with B-cell malignancies
Protocol code: R1979-ONC-1504
Sponsor: Regeneron Pharmaceuticals Inc. (Pharmaceutical company). Phase: Human Pharmacology (Phase I)- First administration to humans. Countries: Spain (ended), Austria (ended), Poland (ended).
Therapeutic area(s): Diseases [C] - Hemic and Lymphatic Diseases [C15]
Gender: Female, Male. Age: 18-64 years, 65+ years. Enrolment: 58.
Status: Ended. Start date (EU): 2024-04-19. End date (EU): 2026-04-29. End date: 2026-04-30. Decision date: 2024-03-25. Results received: No. Last updated: 2026-04-23.
Decision dates by country: AT: 2024-07-22, ES: 2024-03-25, PL: 2024-07-22

Condition(s): B-Cell Non-Hodgkin’s Lymphoma (B-NHL)

Source: https://euclinicaltrials.eu/ctis-public/view/2023-508209-25-00